EU clinical trial 2023-506131-15-00: I4V-MC-JAHX: A Phase 3 Multicenter Study to Evaluate the Long-Term Safety and Efficacy of Baricitinib in Patients from 1 Year to <18 Years of Age with Juvenile Idiopathic Arthritis (JIA)
Protocol code: I4V-MC-JAHX
Sponsor: Eli Lilly & Co. (Pharmaceutical company). Phase: Therapeutic confirmatory (Phase III). Countries: Belgium (ongoing, recruiting), Poland (ongoing, recruiting), France (ongoing, recruiting), Germany (ongoing, recruiting), Spain (ongoing, recruiting), Denmark (ended), Czechia (ongoing, recruiting), Italy (ongoing, recruiting), Austria (ongoing, recruiting).
Therapeutic area(s): Diseases [C] - Musculoskeletal Diseases [C05]
Gender: Female, Male. Age: 0-17 years. Enrolment: 83.
Start date (EU): 2019-09-10. Decision date: 2024-04-04. Results received: No. Last updated: 2026-07-03.
Decision dates by country: AT: 2024-04-09, DK: 2024-04-05, FR: 2024-04-24, IT: 2024-05-15, BE: 2024-04-15, ES: 2024-04-04, CZ: 2024-04-05, PL: 2024-04-19, DE: 2024-04-09

Condition(s): Juvenile Idiopathic Arthritis
Product: BARICITINIB, BARICITINIB, BARICITINIB, Baricitinib

Primary endpoint: Number of participants with one or more SAEs, Number of participants with permanent investigational product discontinuations

Source: https://euclinicaltrials.eu/ctis-public/view/2023-506131-15-00